EU clinical trial 2024-513730-38-00: A phase III clinical trial of adjuvant chemotherapy vs chemo-immunotherapy for stage IB-IIIA completely resected non-small cell lung cancer (NSCLC) patients_NADIM-ADJUVANT
Sponsor: Fundacion GECP (Patient organisation/association). Phase: Therapeutic confirmatory (Phase III). Countries: Spain (ongoing, recruitment ended).
Therapeutic area(s): Diseases [C] - Neoplasms [C04]
Gender: Female, Male. Age: 18-64 years, 65+ years. Enrolment: 210.
Status: Ongoing, recruitment ended. Start date (EU): 2021-01-13. Decision date: 2024-05-20. Results received: No. Last updated: 2026-02-23.

Condition(s): Resectable Non-small cell lung cancer
Product: OPDIVO 10 mg/mL concentrate for solution for infusion.

Primary endpoint: The primary objective is to evaluate the disease-free survival (DFS): defined as the length of time from randomization to the earliest event defined as disease recurrence, any new lung cancer (even in the opposite lung), or death from any cause at any known point in time.
Endpoint(s): Overall survival (OS): defined as the time between the date of randomization and the date of death. OS will be censored on the last date a participant was known to be alive, Safety and tolerability: will be measured by incidence of AE, SAE, immune-related AEs, deaths, and laboratory abnormalities. Adverse events will be graded according to CTCAE v5.0

Source: https://euclinicaltrials.eu/ctis-public/view/2024-513730-38-00